EU clinical trial 2022-501726-38-00: Treatment of KeratolytTreatment of Keratolytic Winter Erythema with systemic nitroxoline, a phase 2a randomized placebo controlled crossover study of male and female adults from three Norwegian familiesic Winter Erythema with systemic Nitroxoline, a phase 2a randomized placebo controlled cross-over study of male and female adults from three Norwegian families.
Protocol code: 1.0
Sponsor: Oslo University Hospital Hf (Hospital/Clinic/Other health care facility). Phase: Therapeutic exploratory (Phase II). Countries: Norway (ended).
Therapeutic area(s): Diseases [C] - Skin and Connective Tissue Diseases [C17]
Gender: Female, Male. Age: 18-64 years, 65+ years. Enrolment: 12.
Status: Ended. Start date (EU): 2023-06-30. End date (EU): 2024-07-19. Decision date: 2022-11-10. Results received: Yes. Last updated: 2023-06-26.

Condition(s): Keratolytic Winter Erythema
Product: NITROXOLINE, Capsules identical to Nitroxolin Forte 250 mg capusules.

Primary endpoint: Relative change from baseline of area (% of cm2) affected by KWE (BSA) during the intervention period compared to that of the placebo period
Endpoint(s): Total area measured during the intervention period compared to that of the placebo period (area under the curve), Time (weeks) to 25%, 50%, 75%, 90% and 100% improvement of area affected by KWE (BSA), Change from baseline in erythema intensity (graded 0-4) caused by KWE during the intervention period compared to that of the placebo period, Change from baseline in desquamation grade caused by KWE during the intervention period compared to that of the placebo period, Visual analog scale (VAS) of water intolerability during the intervention period to that of the placebo period, Visual analog scale (VAS) of hyperhidrosis during the intervention period to that of the placebo period, Visual analog scale (VAS) of pain during the intervention period to that of the placebo period, Mean visual analog scale (VAS) of itch during the intervention period to that of the placebo period, Histologic analysis of skin biopsies obtained at baseline, week 26 and week 52, DLQI scoring every visit during the intervention period compared to that of the placebo period (quality of life), SF-36v2®Health Survey at week 26 and 52 compared to baseline (quality of life), Chalder Fatigue Scale at week 26 and 52 compared to baseline (quality of life), Hospital Anxiety & Depression Scale at week 26 and 52 compared to baseline (quality of life), Adverse events due to study intervention (safety), Abnormalities in physical examination (safety), Abnormalities in laboratory investigations (safety), The compliance of capsule administration will be accounted for. The number of remaining capsules for each participant will be counted at every study control visit.

Source: https://euclinicaltrials.eu/ctis-public/view/2022-501726-38-00